EU clinical trial 2023-504482-23-00: Immune response to the recombinant Zoster Vaccine in people living with HIV over 50 years of age compared to non-HIV age- and gender-matched controls - Shingr'HIV
Protocol code: CHUBX 2022/40
Sponsor: Centre Hospitalier Universitaire De Bordeaux (Hospital/Clinic/Other health care facility). Phase: Therapeutic exploratory (Phase II). Countries: France (ongoing, recruitment ended).
Therapeutic area(s): Diseases [C] - Immune System Diseases [C20]
Gender: Female, Male. Age: 18-64 years, 65+ years. Enrolment: 80.
Status: Ongoing, recruitment ended. Start date (EU): 2023-12-14. Decision date: 2023-07-20. Results received: No. Last updated: 2025-06-25.

Condition(s): Human Immunodeficiency Virus (HIV)
Product: Shingrix powder and suspension for suspension for injection Herpes zoster vaccine (recombinant, adjuvanted)

Primary endpoint: Geometric mean titer (GMT) of gE-specific total IgG measured at D90
Endpoint(s): Incidence of solicited adverse events (AE) in the 7 days following each vaccination (reactogenicity) collected in a diary card: solicited local AE: pain at injection site, injection site swelling, injection site redness, injection site itching, axillary swelling and tenderness of the vaccination arm; solicited systemic AE: fatigue, headache, muscle ache, joint pain, chills, nausea/vomiting, diarrhea, fever, dizziness, Unsolicited AEs for 28 days after each RZV dose, Incidence of SAE throughout the study period, Incidence of potential immune mediated disorders (pIMDs) throughout the study period, In PLWH: Percentage of PLWH with viral load >50 copies/ml one month after the second RZV vaccination (D90), Mean of gE-specific CD4+ T cells expressing at least 2 activation markers (i.e. CD40L, IFN-gamma, IL-2 or TNF-alpha) per million of T cells, measured at D90, Vaccine response rate for antibody defined as percentage of individuals with ≥4-fold increase in the anti-gE antibody concentration as compared to the prevaccination concentration (for initially seropositive participants) or as compared to the anti-gE antibody cut-off value for seropositivity (for initially seronegative participants)., Vaccine response rate for T cells defined as percentage of individuals with a ≥2-fold increase in the frequency of specific CD4+ T cells, as compared to prevaccination frequencies or a ≥2-fold increase above the cut-off (for participants with prevaccination frequencies below the cut-off)., Kinetics of GMT of gE-specific IgG measured at D0, 60, 90 and 360, Kinetics of the gE-specific CD4+ T cells expressing at least 2 activation markers (i.e. CD40L, IFN-gamma, IL-2 or TNF-alpha) per million of T cells measured at D0, 90, and 360, In the Innate subset : Change in the level of serum pro-inflammatory markers (including a panel of cytokines and CRP) between D1 and D0 (first vaccination) and between D60 and D61 (second vaccination); Differential expression of innate and adaptive immune response genes and associated pathways at D1 and D60 compared to D0 (first vaccination) and at D61 and D90 compared to D60 (second vaccination), Change in the functional gE-specific antibody (e.g. ADCC function, binding to Fc receptor (FcR), isotype) at D60, D90 and D360 after RZV vaccination as compared to D0, Percentage of cells among gE-specific T cells expressing activation markers (such as OX-40L, 41BB, CD69), specific transcription factors (such as GATA-3, T-Bet) and other phenotypic markers (e.g naïve vs memory cells) at D0, 90 and 360, Change in TcR repertoire before and after vaccination, Number of gE-specific B cells per millions of PBMC assessed by ELISpot at D0, D90 and D360, Genetic markers measured in blood cells associated with the immunogenicity or reactogenicity profile of RZV, Percentage of innate cells (such as monocytes, dendritic cells, NK cells) expressing intracellular cytokines (e.g. IL-6, TNFa, IP-10) after restimulation in vitro with different innate stimuli, including TLR ligands and interferon-gamma measured at D0 (“innate immune cell fitness”), Level of bioageing markers, such as but not limited to the level of cytosine methylation at specific gene positions in cells and specific serum markers (e.g Dehydroepiandrosterone sulphate, N-glycan, alpha-2 macroglobulin) or genetic markers at D0 (“biological ageing”), Presence of CMV-specific antibodies at D0, Percentage of specific cell types (e.g. T-cell and B-cell subsets, unconventional T cells, NK cells) measured at D0 (“cell phenotyping”), Expansion capacity and differentiation (e.g. change in expression of CD45RA, CD27, CCR7, and T bet expression) of naive and memory T cells upon stimulation with cognate antigens and innate stimuli tested at D0 (“in vitro priming and boosting”), Level of soluble factors associated with ageing (e.g. inflammatory mediators, growth factors, homeostatic cytokines) measured in serum at D0 (“secretome”), Telomere length and telomerase activity measured in PBMC at D0, Functional and epigenetic changes in isolated blood cells (such as monocytes) at D0, D90 and D360, Change in the quantity of HIV DNA copies in PBMC measured at D0 and D90, Frailty score measured at D0 in all participants aged 75 years and above

Source: https://euclinicaltrials.eu/ctis-public/view/2023-504482-23-00